EU clinical trial 2025-524106-14-00: A study in healthy people to test how vicadrostat affects the heart
Protocol code: 1378-0027
Sponsor: Boehringer Ingelheim International GmbH (Pharmaceutical company). Phase: Human Pharmacology (Phase I)- Other. Countries: Germany (ongoing, recruitment ended).
Therapeutic area(s): Not possible to specify
Gender: Female, Male. Age: 18-64 years. Enrolment: 45.
Status: Ongoing, recruitment ended. Start date (EU): 2026-04-20. Decision date: 2026-03-20. Results received: No. Last updated: 2026-03-20.

Condition(s): Healthy volunteer trial

Source: https://euclinicaltrials.eu/ctis-public/view/2025-524106-14-00